EU clinical trial 2024-514762-39-00: A Phase 3, randomized, double-blind, placebo-controlled, parallel-group study to investigate the efficacy and safety of dupilumab for the treatment of pruritus of Lichen Simplex Chronicus (LSC) in adults
Protocol code: EFC18366
Sponsor: Sanofi-Aventis Recherche & Developpement (Pharmaceutical company). Phase: Therapeutic confirmatory (Phase III). Countries: Greece (ongoing, recruitment ended), Germany (ended), Spain (ongoing, recruitment ended), Italy (ongoing, recruitment ended), Hungary (ended), Belgium (ended), Czechia (ended).
Therapeutic area(s): Diseases [C] - Immune System Diseases [C20]
Gender: Female, Male. Age: 18-64 years, 65+ years. Enrolment: 69.
Start date (EU): 2025-03-03. Decision date: 2025-02-04. Results received: No. Last updated: 2026-03-23.
Decision dates by country: CZ: 2025-02-05, DE: 2025-02-06, GR: 2025-02-04, HU: 2025-02-04, IT: 2025-02-04, ES: 2025-02-07, BE: 2025-02-04

Condition(s): Neurodermatitis
Product: Dupilumab, Matched placebo for test product

Primary endpoint: Proportion of participants with improvement (reduction) in weekly average of daily WI-NRS by ≥4 from baseline to Week 24
Endpoint(s): Change in weekly average of daily WI-NRS from baseline to Week 24, Change in weekly average of daily Itch-related Sleep Disturbance NRS from baseline to Week 24, Change in ItchyQoL score from baseline to Week 24, Change in DLQI total score from baseline to Week 24, Proportion of participants with improvement (reduction) in weekly average of daily WI-NRS by ≥4 from baseline to Week 12, Incidence of treatment-emergent anti-drug antibody (ADA) against dupilumab, Percentage of participants experiencing treatment-emergent adverse events (TEAEs) or serious adverse events (SAEs), Percentage change in weekly average of daily WI-NRS from baseline to Week 24, Percentage change in weekly average of daily Itch-related Sleep Disturbance NRS from baseline to Week 24, Proportion of participants with IGA 0 or 1 score for LSC at Week 12 and Week 24, Proportion of participants with both an improvement (reduction) in weekly average of daily WI-NRS by ≥4 from baseline to Week 24 and an IGA 0 or 1 score for LSC at Week 24

Source: https://euclinicaltrials.eu/ctis-public/view/2024-514762-39-00